EU clinical trial 2024-517068-43-00: Selän alueen poikkeava aktiivisuus servikaalisessa dystoniassa
Protocol code: Dystonia
Sponsor: Pirkanmaan hyvinvointialue (Hospital/Clinic/Other health care facility). Phase: Therapeutic use (Phase IV). Countries: Finland (ended).
Therapeutic area(s): Diseases [C] - Nervous System Diseases [C10]
Gender: Female, Male. Age: 18-64 years, 65+ years. Enrolment: 150.
Status: Ended. Start date (EU): 2023-03-27. End date (EU): 2025-05-26. Decision date: 2024-08-27. Results received: Yes. Last updated: 2024-08-27.

Condition(s): Servikaalinen dystonia, jossa poikkeavaa lihasaktiivisuutta esiintyy kaulan alueen lihaksissa aiheuttaen tyypillisiä virheasentoja kuten pään kiertymistä, kallistumista ja vapinaa. Servikaalista dystoniaa hoidetaan ensisijaisesti paikallisesti botuliinitoksiinipistoksilla, jossa poikkeavaa lihasaktiivisuutta pyritään vähentämään lamaamalla kohdelihasten toimintaa
Product: Botox 50 Allergan-yksikköä Injektiokuiva-aine, liuosta varten, Botox 100 Allergan-yksikköä Injektiokuiva-aine, liuosta varten, XEOMIN 50 yksikköä injektiokuiva-aine, liuosta varten, XEOMIN 100 yksikköä injektiokuiva-aine, liuosta varten, Na, NaCl 0,9 % B. Braun, Infusionslösung

Primary endpoint: Dystonian vaikeusasteen muutosta Unified dystonia rating scale (UDRS, Liite I) -asteikon avulla.

Source: https://euclinicaltrials.eu/ctis-public/view/2024-517068-43-00